EU clinical trial 2025-522752-45-00: Prospective, multi-center, randomized, double-blinded, placebo-controlled phase IIb clinical trial to evaluate safety and efficacy of DUOFAG® in bacterial infection treatment in patients with complicated wounds
Protocol code: DUO2025_01
Sponsor: MB PHARMA s.r.o. (Pharmaceutical company). Phase: Phase II and Phase III (Integrated). Countries: Czechia (authorised, recruitment pending).
Therapeutic area(s): Diseases [C] - Bacterial Infections and Mycoses [C01]; Diseases [C] - Skin and Connective Tissue Diseases [C17]
Gender: Female, Male. Age: 18-64 years, 65+ years. Enrolment: 100.
Status: Authorised, recruitment pending. Decision date: 2026-02-09. Results received: No. Last updated: 2026-06-12.

Condition(s): Complicated skin wounds (wounds healing per secundam via granulation tissue) - either as a complication of healing of acute wounds (infected surgical or traumatic wounds) or chronic wounds, in both cases infected with S. aureus and/or P. aeruginosa.
Product: Chlorid sodný B. Braun 0,9 % infuzní roztok, DUOFAG

Primary endpoint: Safety: frequency of all serious (local and systemic) adverse reactions and events (see description in the relevant chapter) suspected or confirmed to be related to IMP administration during the IMP administration phase (0-14 days), Efficiency (1): presence of S. aureus and/or P. aeruginosa colonies on wound swabs over the period of IMP application, Efficiency (2): number of S. aureus and/or P. aeruginosa colonies on wound swabs over the period of IMP application
Endpoint(s): Occurrence and frequency of all (local and systemic) adverse reactions during the treatment and follow-up phase with a suspected or confirmed relatedness to IMP administration, Change in mLUMT score during the treatment and follow-up phase, Time from the start of IMP administration to the point of bacterial infection eradication - negative swab for S. aureus and/or P. aeruginosa, Time from the start of IMP administration until complete wound healing (if this occurs during treatment or follow-up phase), Evaluation of possible differences in efficacy in inpatient and outpatient settings

Source: https://euclinicaltrials.eu/ctis-public/view/2025-522752-45-00